EU clinical trial 2023-507330-24-00: Phase 1/2 Dose Finding, Safety and Efficacy Study of Ibrutinib in Pediatric Subjects with Chronic Graft Versus Host Disease (cGVHD)
Protocol code: PCYC-1146-IM
Sponsor: AbbVie Deutschland GmbH & Co. KG (Pharmaceutical company). Phase: Phase I and Phase II (Integrated)- Other. Countries: France (ended), Italy (ended), Spain (ended), Netherlands (ended), Germany (ended).
Therapeutic area(s): Diseases [C] - Immune System Diseases [C20]
Gender: Female, Male. Age: 0-17 years, 18-64 years. Enrolment: 14.
Status: Ended. Start date (EU): 2019-02-07. End date (EU): 2025-01-20. End date: 2025-10-09. Decision date: 2024-04-08. Results received: Yes. Last updated: 2024-12-17.
Decision dates by country: IT: 2024-04-13, ES: 2024-04-08, DE: 2024-04-11, NL: 2024-04-09, FR: 2024-04-15

Condition(s): Chronic Graft Versus Host Disease (cGVHD)
Product: Ibrutinib, IMBRUVICA 140 mg film-coated tablets, Ibrutinib, Prednison acis 5 mg, Tabletten, Prednison acis 20 mg, Tabletten, Ibrutinib, Prednison acis 50 mg, Tabletten

Primary endpoint: Part A: The primary endpoint is the PK (AUC) to determine the RPED of ibrutinib for use in pediatric subjects (age ≥ 1 to < 12 years) with cGVHD., Part B: The primary endpoint is the PK (AUC) and safety (treatment-emergent AEs and laboratory abnormalities) of ibrutinib in pediatric subjects (age ≥ 1 to < 22 years) with cGVHD.
Endpoint(s): Part A: The secondary endpoints are safety, including treatment-emergent AEs, laboratory abnormalities, and other safety endpoints; pharmacodynamics and for those subjects continuing therapy after dose escalation (Part A Continuation Cohort), secondary endpoints will be the same as outlined under Part B below. B/ Part B: The secondary endpoints include cGVHD response rate at 24 weeks; duration of response; overall survival rate; growth and development in pediatric subjects, Part B: The secondary endpoints include cGVHD response rate at 24 weeks; duration of response; overall survival rate; growth and development in pediatric subjects

Source: https://euclinicaltrials.eu/ctis-public/view/2023-507330-24-00